EU clinical trial 2025-524214-28-00: Randomized, Placebo-Controlled, Double-Blind, Phase 3b Study to Evaluate the Efficacy and Safety of Lerodalcibep in Children and Adolescents, 6 to 17 Years of Age, with Heterozygous Familial Hypercholesterolemia on Stable Diet and Oral Lipid-Lowering Therapy (LIBerate-Kids)
Protocol code: LIB003-008
Sponsor: LIB Therapeutics Inc. (Pharmaceutical company). Phase: Therapeutic confirmatory (Phase III). Countries: Norway (authorised, recruiting).
Therapeutic area(s): Diseases [C] - Nutritional and Metabolic Diseases [C18]
Gender: Female, Male. Age: 0-17 years. Enrolment: 5.
Status: Authorised, recruiting. Start date (EU): 2026-06-25. Decision date: 2026-05-13. Results received: No. Last updated: 2026-06-25.

Condition(s): Heterozygous Familial Hypercholesterolemia
Product: Lerodalcibep, Placebo matching lerodalcibep, solution for injection in pre-filled pen/injector

Primary endpoint: The percent change from baseline compared to placebo in LDL-C level (by preparative ultracentrifugation) at Week 24
Endpoint(s): 1. Percent change in: o LDL-C level at Week 24 (by Hopkins formula and Friedewald); o LDL-C level at Weeks 12, 22 and the mean of Weeks 22 and 24 by Friedewald and Hopkins formula and LDL-C level at Week 24 by preparative ultracentrifugation, 2. Absolute and percent change (where not assessed prior) from baseline in LDL-C level by Friedewald and Hopkins formulas at all visits (Weeks 4, 8, 12, 16, 20, 22, and 24), 3. Serum unbound (free) PCSK9 and PK concentrations in lerodalcibep patients at Day 1, Week 12, and Weeks 22 and 24. Other visits including Weeks 4, 8, 12, 16, and 20 will be measured in response to ADAs in lerodalcibep patients. Samples from placebo patients will be stored, 4. Percentage of patients achieving current pediatric guidelines (EAS Consensus Panel 2015 target LDL-C < 3.5 mmol/L), 5. Growth and development including changes in height, weight, BMI, Tanner staging, and serum hormone levels (eg, estradiol, testosterone, dehydroepiandrosterone, follicle-stimulating hormone [FSH], luteinizing hormone, adrenocorticotropic hormone, and cortisol), 6. Absolute and percent change from baseline in TC, HDL-C, non–HDL-C, VLDL-C, and TG at all visits (Weeks 4, 8, 12, 16, 20, 22, and 24), 7. Absolute and percent change from baseline in ApoB and Lp(a) serum concentrations to Weeks 12, 22 and 24, 8. ADAs will be measured at Day 1 and Weeks 12 and 24/Early Termination (ET) in lerodalcibep patients. Measurements at other visits, including Weeks 4, 8, 16, and 20, may occur if ADAs are detected at Week 24/ET in lerodalcibep patients., 9. The PK concentration for lerodalcibep and total serum PCSK9 will be measured at Weeks 12, 22 and Week 24/ET in lerodalcibep patients. Total serum PCSK9 will also be measured at Day 1. Other visits including Weeks 4, 8, 16, and 20 may be measured to support the population PK plan or the presence of ADAs in lerodalcibep patients., 10. Safety endpoints are AEs, including the frequency of AEs, SAEs, SARs and AEs leading to treatment discontinuation, cardiovascular events and all-cause mortality; safety laboratory parameters (chemistry, hematology, coagulation, and urinalysis), with particular attention to hepatic (eg alanine transaminase/aspartate transaminase, total bilirubin, alkaline phosphatase), fasting glucose and HbA1c and skeletal muscle (ie creatine kinase) toxicities; 12-lead ECGs; ISRs; phys exam and vital signs

Source: https://euclinicaltrials.eu/ctis-public/view/2025-524214-28-00